EU clinical trial 2024-513225-23-00: An Open-label, Multicenter, Phase 2 Study of Sacituzumab Govitecan Combinations in First-line Treatment of Patients with Advanced or Metastatic Non−Small-Cell Lung Cancer (NSCLC) Without Actionable Genomic Alterations
Protocol code: GS-US-576-6220
Sponsor: Gilead Sciences Inc. (Pharmaceutical company). Phase: Therapeutic exploratory (Phase II). Countries: Italy (ended), France (ongoing, recruitment ended), Spain (ongoing, recruitment ended), Germany (ended).
Therapeutic area(s): Diseases [C] - Neoplasms [C04]
Gender: Female, Male. Age: 18-64 years, 65+ years. Enrolment: 156.
Start date (EU): 2022-04-07. Decision date: 2024-07-16. Results received: No. Last updated: 2026-06-24.
Decision dates by country: IT: 2024-08-05, FR: 2024-07-18, DE: 2024-07-17, ES: 2024-07-16

Condition(s): Non-small cell lung cancer
Product: Trodelvy 200 mg powder for concentrate for solution for infusion, Carboplatin 10 mg/ml Concentrate for Solution for Infusion, Cisplatin 1 mg/ml Concentrate for Solution for Infusion, KEYTRUDA 25 mg/mL concentrate for solution for infusion

Primary endpoint: ORR is defined as the proportion of patients who have measurable disease at baseline and achieve a complete response (CR) or partial response (PR) that is confirmed at least 4 weeks later as assessed by an independent review committee (IRC) according to the Response Evaluation Criteria in Solid Tumors (RECIST) Version 1.1., Incidence of DLT(s) (ie, percentage of patients who had DLTs) per dose level during the first 21 days of treatment in the safety run-in cohorts.
Endpoint(s): PFS is defined as the time from the date of the first dose until the date of objective disease progression or death (whichever comes first) as assessed by IRC per RECIST Version 1.1., OS is defined as the time from the date of first dose until death due to any cause., DOR is defined as the time from the first documentation of CR or PR to the earlier of the first documentation of progressive disease (PD) or death from any cause (whichever comes first) as assessed by IRC per RECIST Version 1.1., DCR is defined as the proportion of patients who achieve a CR, PR, or stable disease (SD) as assessed by IRC per RECIST Version 1.1., Incidence of TEAEs and clinical laboratory abnormalities.

Source: https://euclinicaltrials.eu/ctis-public/view/2024-513225-23-00